EU clinical trial 2023-507963-20-00: A Phase 3, Multicenter, 2-Arm Randomized, Open-Label Study of Trastuzumab Deruxtecan in Subjects with HER2 Positive Metastatic and/or Unresectable Gastric or Gastro Esophageal Junction (GEJ) Adenocarcinoma Subjects who have Progressed on or After a Trastuzumab-Containing Regimen (DESTINY-Gastric04)
Protocol code: DS8201-A-U306
Sponsor: Daiichi Sankyo Inc. (Pharmaceutical company). Phase: Therapeutic confirmatory (Phase III). Countries: Hungary (ended), Portugal (ongoing, recruitment ended), Germany (ongoing, recruitment ended), Spain (ongoing, recruitment ended), Romania (ended), Belgium (ongoing, recruitment ended), Poland (ongoing, recruitment ended), France (ongoing, recruitment ended), Ireland (ongoing, recruitment ended), Italy (ongoing, recruitment ended).
Therapeutic area(s): Diseases [C] - Neoplasms [C04]
Gender: Female, Male. Age: 18-64 years, 65+ years. Enrolment: 213.
Start date (EU): 2021-08-19. Decision date: 2024-06-06. Results received: No. Last updated: 2026-06-18.
Decision dates by country: HU: 2024-06-07, PT: 2024-06-07, IT: 2024-06-26, BE: 2024-06-07, IE: 2024-06-06, PL: 2024-06-10, RO: 2024-06-11, DE: 2024-06-07, ES: 2024-06-10, FR: 2024-06-11

Condition(s): Metastatic Gastric Adenocarcinoma
Product: Cyramza 10 mg/ml concentrate for solution for infusion, PACLITAXEL, Cyramza 10 mg/ml concentrate for solution for infusion, DS-8201a, Cyramza 10 mg/ml concentrate for solution for infusion

Primary endpoint: Overall Survival (OS)
Endpoint(s): Progression-Free Survival (PFS), Objective Response Rate (ORR), Duration of Response (DoR), Disease Control Rate (DCR), TEAEs and other safety parameters during the study, PK profile, Immunogenicity (Incidence of ADA and NAb)

Source: https://euclinicaltrials.eu/ctis-public/view/2023-507963-20-00